EU clinical trial 2025-524168-39-00: A clinical study to test MEN2501 in patients with treatment-resistant ovarian cancer
Protocol code: MEN2501-01
Sponsor: Stemline Therapeutics Inc. (Pharmaceutical company). Phase: Human Pharmacology (Phase I)- First administration to humans. Countries: Spain (ongoing, recruiting).
Therapeutic area(s): Diseases [C] - Neoplasms [C04]
Gender: Female. Age: 18-64 years, 65+ years. Enrolment: 23.
Status: Ongoing, recruiting. Start date (EU): 2026-04-13. Decision date: 2026-03-23. Results received: No. Last updated: 2026-03-23.

Condition(s): Platinum-Resistant ovarian cancer

Source: https://euclinicaltrials.eu/ctis-public/view/2025-524168-39-00